EU clinical trial 2025-524477-17-00: PREDICTION OF COMPLICATIONS IN PATIENTS UNDERGOING SURGICAL TREATMENT OF HEPATIC TUMORS
Sponsor: Rigshospitalet (Hospital/Clinic/Other health care facility). Phase: Therapeutic use (Phase IV). Countries: Denmark (authorised, recruitment pending).
Therapeutic area(s): Diseases [C] - Neoplasms [C04]; Diseases [C] - Digestive System Diseases [C06]; Analytical,Diagnostic,Therapeutic Techniques and Equipment [E]-Surgical Procedures, Operative [E04]
Gender: Female, Male. Age: 18-64 years, 65+ years. Enrolment: 192.
Status: Authorised, recruitment pending. Decision date: 2026-03-17. Results received: No. Last updated: 2026-05-13.

Condition(s): Hepatic tumor, Hepatic tumor(s)
Product: [99mTc] Tc-GSA

Primary endpoint: Correlation between Tc-99m GSA SPECT/CT and ICG clearance, Child-Pugh score, MELD score, and ultrasound elastography., Discriminative ability of Tc-99m GSA SPECT/CT compared with standard liver function tests to predict major postoperative complications (Clavien–Dindo ≥ 3)
Endpoint(s): Association of Tc-99m GSA, ICG, Child-Pugh, MELD, and ultrasound elastography with 90-day mortality, post-hepatectomy liver failure, length of stay, and readmission., Model development and internal validation of a multivariable predictive model combining the most accurate liver function test with preoperative clinical factors (frailty, sarcopenia, grip strength, age, sex, etc.) to predict complications.

Source: https://euclinicaltrials.eu/ctis-public/view/2025-524477-17-00